EU clinical trial 2024-515124-36-00: A single-centre, open-label, phase I trial evaluating the pharmacokinetics of single ascending oral doses of IRL757 in healthy elderly volunteers
Protocol code: IRL757C002
Sponsor: Integrative Research Laboratories Sweden AB (Pharmaceutical company). Phase: Human Pharmacology (Phase I)- Other. Countries: Sweden (ended).
Therapeutic area(s): Diseases [C] - Nervous System Diseases [C10]
Gender: Female, Male. Age: 65+ years. Enrolment: 12.
Status: Ended. Start date (EU): 2024-09-24. End date (EU): 2024-11-11. Decision date: 2024-09-09. Results received: No. Last updated: 2024-09-09.

Condition(s): Apathy in neurodegenerative disorders

Source: https://euclinicaltrials.eu/ctis-public/view/2024-515124-36-00